EU clinical trial 2023-509414-11-00: A Phase 1 First-Time-in-Human, Open-Label Study of GSK4381562 Administered as Monotherapy and in Combination with Anticancer Agents in Participants with Selected Advanced Solid Tumors
Protocol code: 217228
Sponsor: Glaxosmithkline Research & Development Limited (Pharmaceutical company). Phase: Human Pharmacology (Phase I)- First administration to humans. Countries: Spain (ongoing, recruitment ended), France (ended).
Therapeutic area(s): Diseases [C] - Neoplasms [C04]
Gender: Female, Male. Age: 18-64 years, 65+ years. Enrolment: 32.
Start date (EU): 2023-05-24. Decision date: 2024-05-14. Results received: No. Last updated: 2026-02-20.
Decision dates by country: FR: 2024-06-04, ES: 2024-05-14

Condition(s): Neoplasms

Source: https://euclinicaltrials.eu/ctis-public/view/2023-509414-11-00